EU clinical trial 2024-514357-29-00: Study of safety and antitumor activity of GEN1056 in participants with advanced solid tumors
Protocol code: GCT1056-01
Sponsor: Genmab A/S (Pharmaceutical company). Phase: Human Pharmacology (Phase I)- First administration to humans. Countries: Spain (ended).
Therapeutic area(s): Diseases [C] - Neoplasms [C04]
Gender: Female, Male. Age: 18-64 years, 65+ years. Enrolment: 18.
Status: Ended. Start date (EU): 2022-11-04. End date (EU): 2025-10-23. End date: 2025-10-23. Decision date: 2024-10-02. Results received: No. Last updated: 2024-10-02.

Condition(s): Advanced solid tumors

Source: https://euclinicaltrials.eu/ctis-public/view/2024-514357-29-00